EU clinical trial 2024-515032-76-00: Phase I/II stUdy of ALoCelyvir in patientS with mEtastaticUveal Melanoma (PULSE-UM)
Sponsor: Fundacio Institut D'Investigacio Biomedica De Bellvitge IDIBELL (Laboratory/Research/Testing facility). Phase: Phase I and Phase II (Integrated)- Other. Countries: Spain (ended).
Therapeutic area(s): Diseases [C] - Neoplasms [C04]
Gender: Female, Male. Age: 18-64 years, 65+ years. Enrolment: 16.
Status: Ended. Start date (EU): 2021-11-10. End date (EU): 2025-09-09. Decision date: 2024-09-06. Results received: No. Last updated: 2024-09-06.

Condition(s): mEtastatic Uveal Melanoma
Product: AloCelyvir

Primary endpoint: Efficacy measured by ORR according to the RECIST 1.1 criteria.
Endpoint(s): -Progression Free Survival (PFS) according to RECIST 1.1 criteria, Overall Survival (OS) rate and Estimated Survival rate at 1, and 2-years

Source: https://euclinicaltrials.eu/ctis-public/view/2024-515032-76-00